EU clinical trial 2024-511263-28-00: Efficacy, safety, tolerability and quality of life of ongoing individually optimized lipid-lowering therapy with or without inclisiran (KJX839) – a randomized, placebo-controlled, double-blind multicenter phase IV study in participants with hypercholesterolemia
Protocol code: CKJX839A12402
Sponsor: Novartis Pharma AG (Pharmaceutical company). Phase: Therapeutic use (Phase IV). Countries: Bulgaria (ended), Poland (ended), France (ended), Estonia (ended), Latvia (ended), Czechia (ended), Spain (ended), Germany (ended).
Therapeutic area(s): Diseases [C] - Cardiovascular Diseases [C14]
Gender: Female, Male. Age: 18-64 years, 65+ years. Enrolment: 1776.
Status: Ended. Start date (EU): 2022-04-08. End date (EU): 2025-03-19. End date: 2025-03-20. Decision date: 2024-07-05. Results received: Yes. Last updated: 2025-04-02.
Decision dates by country: BG: 2024-07-05, EE: 2024-07-19, FR: 2024-07-09, LV: 2024-07-05, ES: 2024-07-05, PL: 2024-07-09, CZ: 2024-07-09, DE: 2024-07-08

Condition(s): Hypercholesterolemia
Product: ROSUVASTATIN, ROSUVASTATIN, ROSUVASTATIN, ROSUVASTATIN, Placebo to KJX839 (Inclisiran sodium) 0 mg/1.5 mL solution for injection in pre-filled syringe, INCLISIRAN

Primary endpoint: Proportion of participants achieving individual LDL-C target (< 55 mg/dL or < 70 mg/dL) at day 90
Endpoint(s): Relative change (percentage from baseline to mean LDL-C level) over the double-blind treatment period., Proportion of participants experiencing at least one muscle-related AE as defined in the Standardized MedDRA Queries (SMQ) rhabdomyolysis / myopathy from day 1 to day 360., Proportion of participants experiencing self-reported pain. Annualized number of days participants experiencing self-reported pain from baseline to day 360., Change from baseline in SF-BPI pain severity score to day 360. Change from baseline in SF-BPI pain interference score to day 360. Proportion of participants with clinically relevant change in SF-BPI pain severity score from baseline to day 360. Proportion of participants with clinically relevant change in SF-BPI pain interference score from baseline to day 360.

Source: https://euclinicaltrials.eu/ctis-public/view/2024-511263-28-00